EU clinical trial 2025-524181-26-00: A Phase 2, Open-Label, Single-Arm, Multicenter Study to Evaluate the Efficacy of Cemsidomide + Dexamethasone in Subjects With Relapsed/Refractory Multiple Myeloma (r/r MM)
Protocol code: CFT7455-2101
Sponsor: C4 Therapeutics Inc. (Pharmaceutical company). Phase: Therapeutic exploratory (Phase II). Countries: Italy (authorised, recruitment pending), France (authorised, recruitment pending), Spain (authorised, recruitment pending), Poland (authorised, recruitment pending).
Therapeutic area(s): Diseases [C] - Hemic and Lymphatic Diseases [C15]
Gender: Female, Male. Age: 18-64 years, 65+ years. Enrolment: 43.
Status: Authorised, recruitment pending. Decision date: 2026-05-25. Results received: No. Last updated: 2026-05-27.
Decision dates by country: FR: 2026-05-26, IT: 2026-05-27, ES: 2026-05-26, PL: 2026-05-25

Condition(s): relapsed/refractory multiple myeloma
Product: Cemsidomide

Primary endpoint: Overall response rate (ORR) per International Myeloma Working Group (IMWG) Response Criteria by an Independent Review Committee (IRC)
Endpoint(s): Duration of response, Complete response (CR) rate, Time to response, Progression free survival, Overall survival, Frequency and severity of adverse events (AEs); serious AEs (SAEs); AEs leading to treatment interruption, reduction, or discontinuation; and deaths, Plasma concentrations of cemsidomide

Source: https://euclinicaltrials.eu/ctis-public/view/2025-524181-26-00